EU clinical trial 2025-522872-10-00: A Multicenter, Long-term, Open-Label, Safety, Tolerability, and Efficacy Study of Azetukalner in Bipolar I or II Depression
Protocol code: XPF-010-B302
Sponsor: Xenon Pharmaceuticals Inc. (Pharmaceutical company). Phase: Therapeutic confirmatory (Phase III). Countries: Bulgaria (authorised, recruitment pending), Germany (authorised, recruitment pending), France (ended), Spain (authorised, recruitment pending).
Therapeutic area(s): Psychiatry and Psychology [F] - Mental Disorders [F03]
Gender: Female, Male. Age: 18-64 years, 65+ years. Enrolment: 70.
Decision date: 2026-04-28. Results received: No. Last updated: 2026-05-05.
Decision dates by country: BG: 2026-05-04, FR: 2026-04-28, DE: 2026-04-29, ES: 2026-05-04

Condition(s): Depressive episodes associated with Bipolar disorder I or II (Bipolar Depression)
Product: XPF-010

Primary endpoint: Severity and frequency of TEAEs, SAEs, AESIs and ECIs
Endpoint(s): Change from baseline in the MADRS total score over time., Change in CGI-S score over time., Change from baseline in the SHAPS total score over time.

Source: https://euclinicaltrials.eu/ctis-public/view/2025-522872-10-00